EU clinical trial 2023-505057-40-00: A Phase 2, Randomized, Open-label, Platform Study Utilizing a Master Protocol to Evaluate Novel Immunotherapy Combinations in Participants with Previously Untreated, Locally Advanced/Metastatic, Programmed Death Ligand 1-Selected Non Small Cell Lung Cancer
Protocol code: 213824
Sponsor: Glaxosmithkline Research & Development Limited (Pharmaceutical company). Phase: Therapeutic exploratory (Phase II). Countries: Portugal (ongoing, recruitment ended), Hungary (ended), Italy (ongoing, recruitment ended), Belgium (ended), Germany (ongoing, recruitment ended), Spain (ongoing, recruitment ended), Netherlands (ongoing, recruitment ended), Finland (ended), France (ongoing, recruitment ended), Poland (ongoing, recruitment ended), Greece (ongoing, recruitment ended).
Therapeutic area(s): Diseases [C] - Neoplasms [C04]
Gender: Female, Male. Age: 18-64 years, 65+ years. Enrolment: 174.
Start date (EU): 2022-12-02. Decision date: 2024-06-11. Results received: No. Last updated: 2025-11-18.
Decision dates by country: DE: 2024-06-17, HU: 2024-06-12, BE: 2024-06-11, PL: 2024-07-05, IT: 2024-06-17, NL: 2024-06-11, FR: 2024-06-19, GR: 2024-08-22, ES: 2024-06-17, PT: 2024-06-11, FI: 2024-06-11

Condition(s): Lung Cancer, Non-Small Cell
Product: JEMPERLI 500 mg concentrate for solution for infusion, KEYTRUDA 25 mg/mL concentrate for solution for infusion

Primary endpoint: Incidence of TEAEs and SAEs Incidence of TEAEs/SAEs leading to dose modifications (e.g., dose delay) or study intervention discontinuation

Source: https://euclinicaltrials.eu/ctis-public/view/2023-505057-40-00